EU clinical trial 2024-510990-21-00: A Phase 2/3, Multicenter, Double-Blind, Randomized Study to Determine the Efficacy and Safety of Tividenofusp Alfa (DNL310) vs Idursulfase in Pediatric and Young Adult Participants With Neuronopathic or Non-Neuronopathic Mucopolysaccharidosis Type II
Protocol code: DNLI-E-0007
Sponsor: Denali Therapeutics Inc. (Pharmaceutical company). Phase: Phase II and Phase III (Integrated). Countries: Belgium (ongoing, recruiting), Netherlands (ongoing, recruiting), Germany (ongoing, recruiting), France (ongoing, recruiting), Italy (ongoing, recruiting), Czechia (ongoing, recruiting), Spain (ongoing, recruiting), Sweden (ongoing, recruiting).
Therapeutic area(s): Diseases [C] - Nervous System Diseases [C10]
Gender: Female, Male. Age: 0-17 years, 18-64 years. Enrolment: 32.
Status: Ongoing, recruiting. Start date (EU): 2022-11-11. Decision date: 2024-11-15. Results received: No. Last updated: 2026-04-13.
Decision dates by country: NL: 2024-12-03, DE: 2024-11-19, FR: 2024-11-19, IT: 2024-11-25, CZ: 2024-11-15, BE: 2024-11-25, ES: 2024-11-15, SE: 2024-11-15

Condition(s): Mucopolysaccharidosis Type II [MPS II]
Product: Elaprase 2 mg/ml concentrate for solution for infusion

Primary endpoint: Ratio to baseline in CSF HS concentration at Week 24 (Cohort A), Change from baseline in the Vineland-3 at Week 96 (Cohort A)
Endpoint(s): Change from baseline in the Bayley Scales of Infant and Toddler Development, Third Edition (BSID-III) at Week 96 (Cohort A only), Change from baseline in the Vineland-3 ABC score at Week 96 (Cohort A only), Ratio to baseline in serum NfL at Week 96 (Cohort A only), Change from baseline in distance walked (meters) in the 6MWT at Week 48 (Cohort B only), Ratio to baseline in the sum of urine HS and DS concentrations (normalized to creatinine) at Week 24 (Cohorts A and B), Ratio to baseline in the sum of urine HS and DS concentrations (normalized to creatinine) at Week 48 (Cohorts A and B), Liver volume within the normal range (normal vs abnormal) as measured by magnetic resonance imaging (MRI) at Week 48 (Cohorts A and B), Spleen volume within the normal range (normal vs abnormal) as measured by MRI at Week 48 (Cohorts A and B), Improvement in Parent/Caregiver Global Impression of Change (CaGI-C) Overall MPS II at Week 48 (Cohorts A and B)

Source: https://euclinicaltrials.eu/ctis-public/view/2024-510990-21-00